EU clinical trial 2024-520020-28-00: PILOT ANTI-CMV CLINICAL TRIAL: PROPHYLAXIS OF CYTOMEGALOVIRUS INFECTION IN HLA-IDENTICAL FAMILIAL ALLOGENEIC HEMATOPOIETIC STEM CELL TRANSPLANTATION WITH ADVANCED CELLULAR IMMUNOTHERAPY IN PATIENTS WITHOUT SPECIFIC PHARMACOLOGYCAL PROPHYLAXIS AVAILABLE
Protocol code: INMUNOCELL-CTMV
Sponsor: Instituto De Investigacion Marques De Valdecilla (Laboratory/Research/Testing facility). Phase: Phase I and Phase II (Integrated)- First administration to humans. Countries: Spain (authorised, recruitment pending).
Therapeutic area(s): Diseases [C] - Virus Diseases [C02]
Gender: Female, Male. Age: 18-64 years, 65+ years. Enrolment: 32.
Status: Authorised, recruitment pending. Decision date: 2025-01-17. Results received: No. Last updated: 2026-01-02.

Condition(s): Cytomegalovirus infection post allogeneic allogeneic HLA-identical familial PHT

Primary endpoint: efficacy is the incidence of CMV infection AT DAY 100 POST-TPH (measured as viral load >200 copies in 2 determinations or >1000 in 1 determination [PCRq]).
Endpoint(s): Assess the need for CMV treatment, To evaluate the incidence of CMV disease, to assess the presence of allogeneic CMV-specific memory T lymphocytes

Source: https://euclinicaltrials.eu/ctis-public/view/2024-520020-28-00